EU clinical trial 2024-518937-26-00: Efficacy and safety of the combination of Cisplatin plus Nab-paclitaxel and Nivolumab with radiotherapy after maximal tumor resection in non-metastatic muscle invasive Bladder Cancer. (CA209-6E8, CNN-BC trial)
Protocol code: CA209-6E8, CNN-BC
Sponsor: Fondazione Policlinico Universitario Agostino Gemelli IRCCS (Hospital/Clinic/Other health care facility). Phase: Therapeutic exploratory (Phase II). Countries: Italy (ongoing, recruiting).
Therapeutic area(s): Diseases [C] - Neoplasms [C04]
Gender: Female, Male. Age: 18-64 years, 65+ years. Enrolment: 24.
Status: Ongoing, recruiting. Start date (EU): 2023-02-21. Decision date: 2024-11-26. Results received: No. Last updated: 2026-07-23.

Condition(s): Patients with non-metastatic muscle invasive bladder cancer
Product: PACLITAXEL ALBUMIN-BOUND, NIVOLUMAB, CISPLATIN

Primary endpoint: The primary end point is one –year disease–free survival, which will be defined as the rate of survival free of recurrence in pelvic nodes or bladder (cis excluded), or appearance of distant metastasis with data censored at the first sign of disease or second primary tumor, or death
Endpoint(s): To describe the rate of patients who require salvage cystectomy, To describe the rate of locoregional complete response, To describe the rate of locoregional disease-free survival, To describe the median disease-free survival, To describe the median metastasis-free survival, To describe the safety of the combination of nivolumab plus cisplatin and nab-paclitaxel with concomitant RT, To describe the safety of nivolumab after RT, Quality of life

Source: https://euclinicaltrials.eu/ctis-public/view/2024-518937-26-00